EU clinical trial 2025-521170-33-00: REDI-CaP (Recovery of Erectile Dysfunction Induced in Prostate Cancer Patients). Innovative Management of Patients with Unfavorable Intermediate-Risk Prostate Cancer: a Special Focus on Quality of Life and Erectile Function Recovery
Sponsor: IRCCS Istituto Nazionale Tumori Fondazione Pascale (Hospital/Clinic/Other health care facility). Phase: Therapeutic exploratory (Phase II). Countries: Italy (ongoing, recruiting).
Therapeutic area(s): Diseases [C] - Neoplasms [C04]
Gender: Male. Age: 18-64 years, 65+ years. Enrolment: 50.
Status: Ongoing, recruiting. Start date (EU): 2025-11-05. Decision date: 2025-07-17. Results received: No. Last updated: 2026-05-13.

Condition(s): Prostate Cancer
Product: Orgovyx 120 mg film-coated tablets

Primary endpoint: Assessment of the International Index of Erectile Function-5 (IIEF-5) score at six months after hormonal therapy cessation, indicating recovery in at least 70% of the study population.
Endpoint(s): Time from hormonal therapy cessation to sexual function recovery relative to pre-treatment levels (SFRT), Correlation of erectile function recovery with dose to the penile bulb, crura, internal pudendal artery, periprostatic neurovascular bundles, and testes, bPFS per Phoenix criteria (nadir + 2 ng/mL), Local control, defined as time from treatment to local recurrence or last follow-up, dPFS, defined as time from treatment to distant metastases or last follow-up, Acute and late urinary and rectal toxicity, measured using RTOG and IPSS scales, QoL scores from questionnaires (EORTC QLQ-C30, PR25, IIEF-5), Financial toxicity assessment (PROFFIT questionnaire), OS, defined as time from treatment to death or last follow-up

Source: https://euclinicaltrials.eu/ctis-public/view/2025-521170-33-00